EU clinical trial 2024-518296-56-00: A Phase 3, Randomized, Double-Blind, Placebo-Controlled Program to Evaluate the Efficacy and Safety of Tulisokibart in Participants with Moderately to Severely Active Crohn’s Disease
Protocol code: MK-7240-008 study 2
Sponsor: Merck Sharp & Dohme LLC (Pharmaceutical company). Phase: Therapeutic confirmatory (Phase III). Countries: Spain (ongoing, recruiting), Austria (ongoing, recruiting), Lithuania (ongoing, recruiting), France (ongoing, recruiting), Belgium (ongoing, recruiting), Germany (ongoing, recruiting), Sweden (ongoing, recruiting), Czechia (ongoing, recruiting), Finland (ongoing, recruiting), Croatia (ongoing, recruiting), Latvia (ongoing, recruiting), Portugal (ongoing, recruiting), Netherlands (ongoing, recruiting), Italy (ongoing, recruiting), Denmark (authorised, recruiting), Slovakia (ongoing, recruiting), Romania (authorised, recruiting), Poland (ongoing, recruiting), Ireland (ended), Hungary (ongoing, recruiting), Greece (ongoing, recruiting).
Therapeutic area(s): Diseases [C] - Digestive System Diseases [C06]
Gender: Female, Male. Age: 18-64 years, 65+ years. Enrolment: 567.
Start date (EU): 2025-09-29. Decision date: 2025-09-03. Results received: No. Last updated: 2026-08-04.
Decision dates by country: RO: 2025-10-07, FR: 2025-10-03, SK: 2025-09-03, FI: 2025-09-04, DK: 2025-09-04, NL: 2025-09-05, AT: 2025-09-05, LT: 2025-09-08, GR: 2025-09-04, IE: 2025-09-05, LV: 2025-09-04, DE: 2025-09-04, IT: 2025-09-04, HU: 2025-09-03, BE: 2025-09-04, HR: 2025-09-08, SE: 2025-09-05, PL: 2025-10-15, CZ: 2025-09-05, PT: 2025-10-16, ES: 2025-09-05

Condition(s): Crohn’s Disease
Product: tulisokibart, Placebo to MK-7240, tulisokibart

Primary endpoint: Study 2: [US/FDA Only] Percentage of Participants Achieving Clinical Remission per CDAI Score at Week 12, Study 2: [EU/EMA Only] Percentage of Participants Achieving Clinical Remission per Stool Frequency and Abdominal Pain Score at Week 12, Study 2: Percentage of Participants Achieving Endoscopic Response at Week 12
Endpoint(s): Study 2: Percentage of Participants in Diagnostic Assay Positive (Dx+) Subpopulation Achieving Clinical Remission per CDAI at Week 12, Study 2: Percentage of Participants in Diagnostic Assay Positive (Dx+) Subpopulation Achieving Endoscopic Response at Week 12, Study 2: Number of Participants Who Experienced an Adverse Event (AE), Study 2: Number of Participants who Discontinue Study Intervention due to an AE, Study 2 [US/FDA Only]: Percentage of Participants Achieving Clinical Remission per Stool Frequency and Abdominal Pain Score at Week 12, Study 2 [EU/EMA Only]: Percentage of Participants Achieving Clinical Remission per CDAI Score at Week 12, Study 2: Percentage of Participants with Decrease of ≥100 Points in CDAI Score from Baseline to Week 12, Study 2: Mean Change from Baseline in FACIT-Fatigue Score at Week 12, Study 2: Percentage of Participants Achieving Endoscopic Remission at Week 12, Study 2: Mean Change from Baseline in Inflammatory Bowel Disease Questionnaire (IBDQ) Score at Week 12, Study 2: Percentage of Participants with Decrease of ≥100 Points in CDAI Score from Baseline to Week 6, Study 2: Percentage of Participants with Ulcer-Free Endoscopy at Week 12

Source: https://euclinicaltrials.eu/ctis-public/view/2024-518296-56-00